EU clinical trial 2024-516182-37-01: TALazoparib and Avelumab as maintenance therapy in platinum-Sensitive metastatic or locally advanced URothelial carcinoma: A single-arm Phase 2 trial
Protocol code: TALASUR
Sponsor: Centre Francois Baclesse (Hospital/Clinic/Other health care facility). Phase: Therapeutic exploratory (Phase II). Countries: France (authorised, recruitment pending).
Therapeutic area(s): Diseases [C] - Neoplasms [C04]
Gender: Female, Male. Age: 18-64 years, 65+ years. Enrolment: 45.
Status: Authorised, recruitment pending. Decision date: 2024-12-06. Results received: No. Last updated: 2024-12-06.

Condition(s): Maintenance treatment in patients with locally advanced/metastatic urothelial carcinoma

Source: https://euclinicaltrials.eu/ctis-public/view/2024-516182-37-01